EU clinical trial 2023-508692-36-00: Feasibility and tolerability of 28 days intravaginal oxybutynin via the MedRing OAB system
Protocol code: MedRing06
Sponsor: LiGalli B.V. (Pharmaceutical company). Phase: Human Pharmacology (Phase I)- Other. Countries: Netherlands (ended).
Therapeutic area(s): Diseases [C] - Female Urogenital Diseases and Pregnancy Complications [C13]
Gender: Female. Age: 18-64 years, 65+ years. Enrolment: 12.
Status: Ended. Start date (EU): 2024-02-06. End date (EU): 2024-08-27. Decision date: 2024-02-05. Results received: No. Last updated: 2024-03-29.
Decision dates by country: NL: 2024-03-29

Condition(s): Overactive bladder

Source: https://euclinicaltrials.eu/ctis-public/view/2023-508692-36-00